EU clinical trial 2025-524841-28-00: KET01-IIT03: A Pilot, Open-label Phase II Trial of Adjunctive Treatment with Ketamine Hydrochloride Prolonged-Release Tablets (KET01) during the Initiation of Antidepressant Therapy in Major Depressive Disorder
Sponsor: Region Skane (Hospital/Clinic/Other health care facility). Phase: Therapeutic exploratory (Phase II). Countries: Sweden (ended).
Therapeutic area(s): Psychiatry and Psychology [F] - Mental Disorders [F03]
Gender: Female, Male. Age: 18-64 years, 65+ years. Enrolment: 12.
Status: Ended. Start date (EU): 2026-03-13. End date (EU): 2026-06-17. Decision date: 2026-03-05. Results received: No. Last updated: 2026-03-05.

Condition(s): Major Depressive Disorder
Product: Ketamine hydrochloride prolonged release tablets

Primary endpoint: Change in total Montgomery-Åsberg Depression Rating Scale (MADRS) score after one week of treatment (day 8) compared to the baseline visit (day 1).
Endpoint(s): Change in total MADRS score between baseline (day 1) and day 3, 5, 15 and 29., Change in Clinical Global Impression – Severity (CGI-S) rating scale from baseline (day 1) to every post-baseline measurement (day 3, 5, 8, 15, 29), Total score of Clinical Global Impression – Efficacy Index (CGI-E) rating scale at every post-baseline measurement (day 3, 5, 8, 15, 29), Change in Patient Health Questionnaire-9 (PHQ-9) between baseline (day 1) and the two follow-up visits (day 15 and 29), Change in composite inflammatory depressive symptom score (InfDep score) consisting of PHQ-9 items # 3, 4 and 5 between baseline (day 1) and the two follow-up visits (day 15 and 29), Change in generalized anxiety disorder-7 (GAD-7) between baseline (day 1) and the two follow-up visits (day 15 and 29), Change in Columbia Suicide Severity Rating Scale (C-SSRS) between baseline (day 1) and three post-baseline visits (day 8, 15, 29), Response rate (≥ 50% decrease from baseline in MADRS total score) at every post-baseline visit (day 3, 5, 8, 15, 29)., Remission rate (MADRS score of ≤10) at every post-baseline visit (day 3, 5, 8, 15, 29)., Change in Sedentary Behaviour (SED), Low-Intensity Physical Activity (LPA) and Moderate- to Vigorous Physical Activity (MVPA) and number of steps, between baseline (day 1) and every post-baseline visit (day 3, 5, 8, 15, 29)., Change in sleep patterns total sleep time (TST), sleep efficiency (SE), wake after sleep onset (WASO) and number of awakenings (NA) between baseline (day 1) and every post-baseline visit (day 3, 5, 8, 15, 29)., Changes in blood plasma levels of the inflammatory biomarkers high-sensitive C-reactive protein, interleukin-6, tumor necrosis factor alpha and white blood cell count between baseline (day 1) and three post-baseline visits (day 8, 15, 29)., Change in DNA methylation patterns between baseline (day 1) and two post-baseline visits (day 8 and day 29)., Change in Connor-Davidsson Resilience Scale (CD-RISC-25) between baseline (day 1) and two post-baseline visits (day 8 and 29)., Patient's personal experience with effect of ketamine treatment on mood (qualitative interview with open-ended question at last follow-up (day 29)).

Source: https://euclinicaltrials.eu/ctis-public/view/2025-524841-28-00